EU clinical trial 2022-500630-29-00: A Phase 3 Randomized, Double-blind, Multi-center Study of Adjuvant Nivolumab versus Placebo in Subjects with High Risk Invasive Urothelial Carcinoma
Protocol code: CA209-274
Sponsor: Bristol-Myers Squibb Services Unlimited Company (Pharmaceutical company). Phase: Therapeutic confirmatory (Phase III). Countries: France (ended), Denmark (ended), Greece (ended), Romania (ended), Germany (ended), Austria (ended), Netherlands (ended), Ireland (ended), Spain (ended), Italy (ended), Sweden (ended), Belgium (ended), Poland (ended).
Therapeutic area(s): Diseases [C] - Neoplasms [C04]
Gender: Female, Male. Age: 18-64 years, 65+ years. Enrolment: 165.
Status: Ended. Start date (EU): 2016-05-06. End date (EU): 2026-05-08. End date: 2026-05-20. Decision date: 2022-08-11. Results received: No. Last updated: 2026-06-02.
Decision dates by country: DK: 2022-08-11, SE: 2022-08-12, RO: 2022-08-12, AT: 2022-08-16, FR: 2022-08-12, DE: 2022-08-12, IT: 2022-08-11, BE: 2022-08-16, IE: 2022-08-11, ES: 2022-08-16, PL: 2022-09-12, NL: 2022-08-16, GR: 2022-08-12

Condition(s): Subjects with High Risk Invasive Urothelial Carcinoma
Product: MDX1106 ONO-4538, 5% Dextrose injection, OPDIVO 10 mg/mL concentrate for solution for infusion., 0.9% sodium chloride injection. Solution for injection.

Primary endpoint: Disease Free Survival - This endpoint will be analyzed in two different populations (co-primary): Subjects with PD-L1 expression level >=1% and all randomized subjects
Endpoint(s): To compare Non-Urothelial Tract Recurrence Free Survival (NUTRFS) for nivolumab versus placebo in subjects with tumors expressing PD-L1 (>= 1% membranous staining in tumor cells) and all randomized subjects, To compare the Disease Specific Survival (DSS) for nivolumab and placebo in subjects with tumors expressing PD-L1 (>=1% membranous staining in tumor cells) and all randomized subjects, To compare the Overall Survival (OS) for nivolumab versus placebo in subjects with tumors expressing PD-L1 (>=1% membranous staining in tumor cells) and all randomized subjects

Source: https://euclinicaltrials.eu/ctis-public/view/2022-500630-29-00